EU clinical trial 2025-523374-17-03: Insulin resistance in type 2 diabetes: evaluating the pathogenic mechanisms of insulin resistance in the myocardium and the effects of the treatments with GLP-1RA and SGLT2i
Protocol code: PI24/01356
Sponsor: Fundacio Hospital Universitari Vall D’Hebron Institut De Recerca (Laboratory/Research/Testing facility). Phase: Therapeutic use (Phase IV). Countries: Spain (authorised, recruitment pending).
Therapeutic area(s): Diseases [C] - Nutritional and Metabolic Diseases [C18]; Diseases [C] - Cardiovascular Diseases [C14]
Gender: Female, Male. Age: 18-64 years, 65+ years. Enrolment: 60.
Status: Authorised, recruitment pending. Decision date: 2026-06-19. Results received: No. Last updated: 2026-06-19.

Condition(s): Type 2 diabetes
Product: Dapagliflozin 10 mg film-coated tablets, Ozempic 1 mg solution for injection in pre-filled pen

Primary endpoint: Myocardium insulin resistance
Endpoint(s): Coronary flow, Heart function

Source: https://euclinicaltrials.eu/ctis-public/view/2025-523374-17-03